EU clinical trial 2024-512222-28-00: SIOP Ependymoma Program II: An International Clinical Program for the diagnosis and treatment of children, adolescents and young adults with ependymoma
Protocol code: ET-13-002
Sponsor: Centre Leon Berard (Hospital/Clinic/Other health care facility). Phase: Phase II and Phase III (Integrated). Countries: France (ongoing, recruiting), Italy (ongoing, recruiting), Denmark (ongoing, recruiting), Austria (ongoing, recruiting), Netherlands (ongoing, recruiting), Norway (ongoing, recruiting), Czechia (ongoing, recruiting), Spain (ongoing, recruiting), Finland (ongoing, recruiting), Ireland (ongoing, recruiting), Germany (ongoing, recruiting), Greece (ongoing, recruiting), Belgium (ongoing, recruiting).
Therapeutic area(s): Diseases [C] - Neoplasms [C04]
Gender: Female, Male. Age: 0-17 years, 18-64 years. Enrolment: 894.
Status: Ongoing, recruiting. Start date (EU): 2015-06-02. Decision date: 2024-11-13. Results received: No. Last updated: 2026-06-10.
Decision dates by country: NO: 2024-11-14, DK: 2024-11-15, AT: 2024-12-02, GR: 2024-12-09, NL: 2024-11-15, FI: 2024-11-18, IT: 2024-11-19, DE: 2024-11-28, ES: 2024-11-15, CZ: 2024-11-13, IE: 2024-11-13, BE: 2024-11-18, FR: 2024-11-25

Condition(s): Newly diagnosed with an intracranial or spinal ependymoma (all WHO grades) including ependymoma variants: cellular, papillary, myxopapillary, clear-cell and tanycytic or anaplastic ependymoma.
Product: Etoposide 20 mg/ml Concentrate for Solution for Infusion, Cisplatin 1 mg/ml Sterile Concentrate, Methotrexate 100 mg/ml Injection, Vincristine Sulfate 1 mg/ml solution for injection, Epilim Syrup 200 mg/5 ml, Cyclophosphamide 2000 mg Powder for Solution for Injection or Infusion

Primary endpoint: Overall program : Gross Total Resection (GTR) rate, Stratum 1 and 3 : Progression Free Survival (PFS), Stratum 2 : Number of treatment responders (according to central radiological review)
Endpoint(s): Overall program : Second look surgery rate, All interventional strata : Efficacy in each molecular sub-group in terms of PFS and OS, All interventional strata : Overall Survival, All interventional strata : Neuroendocrine outcomes, All interventional strata : Neuropsychological outcomes, All interventional strata : Quality of Survival, All interventional strata : Adverse events (CTCAE v4.03), Stratum 2 : The concordance rate between central and local radiological reviews will be described as the proportion of patients in whom the result of the central radiological review confirms the local review., Stratum 2 : Progression Free Survival, Stratum 3 : Radiotherapy-free survival rate

Source: https://euclinicaltrials.eu/ctis-public/view/2024-512222-28-00